EU clinical trial 2023-507665-25-00: A randomized, double-blind, placebo-controlled, parallel-group study to assess the efficacy, safety, and tolerability of dexpramipexole administered orally for 52 weeks in participants with severe eosinophilic asthma (EXHALE-2)
Protocol code: AR-DEX-22-01
Sponsor: Areteia Therapeutics Inc. (Pharmaceutical company). Phase: Therapeutic confirmatory (Phase III). Countries: Romania (ended), Bulgaria (ended), Poland (ended).
Therapeutic area(s): Diseases [C] - Respiratory Tract Diseases [C08]
Gender: Female, Male. Age: 0-17 years, 18-64 years, 65+ years. Enrolment: 430.
Status: Ended. Start date (EU): 2023-04-25. End date (EU): 2025-11-05. Decision date: 2024-09-23. Results received: No. Last updated: 2025-09-19.
Decision dates by country: RO: 2024-09-23, PL: 2024-09-30, BG: 2024-09-24

Condition(s): Severe Eosinophilic asthma
Product: Dexpramipexole (KNS-760704), Placebo, Dexpramipexole (KNS-760704)

Primary endpoint: Annualized rate of severe asthma exacerbations (AAER) over 52 weeks.
Endpoint(s): Pre-BD FEV1, absolute change from baseline, averaged across visits at Weeks 36, 44, and 52., Asthma Control Questionnaire-6 (ACQ-6), change from baseline, averaged across visits at Weeks 36, 44, and 52., Standardized version of the Asthma Quality of Life Questionnaire for 12 years and older (AQLQ+12) change from baseline to Week 52.

Source: https://euclinicaltrials.eu/ctis-public/view/2023-507665-25-00